EU clinical trial 2023-510504-45-00: Fecal Microbiota Transplantation to RESCUE patients with unresectable Hcc progressors to first line therapy with AtezolizUmaB and Bevacizumab (RESCUE-HUB)
Protocol code: RESCUE-HUB
Sponsor: Azienda Ospedaliero-Universitaria Di Bologna IRCCS Istituto Di Ricerca E Di Cura A Carattere Scientifico (Hospital/Clinic/Other health care facility). Phase: Therapeutic exploratory (Phase II). Countries: Italy (ongoing, recruiting).
Therapeutic area(s): Diseases [C] - Neoplasms [C04]
Gender: Female, Male. Age: 18-64 years, 65+ years. Enrolment: 15.
Status: Ongoing, recruiting. Start date (EU): 2026-05-14. Decision date: 2024-08-19. Results received: No. Last updated: 2026-07-31.

Condition(s): unresectable hepatocellular carcinoma (HCC)
Product: ZENGAC “500 mg Polvere per soluzione per infusione e per uso orale”, Avastin 25 mg/ml concentrate for solution for infusion., Plenvu, polvere per soluzione orale, Tecentriq 1 200 mg concentrate for solution for infusion, SELG ESSE polvere per soluzione orale, Vancomicina Mylan 500 mg polvere per soluzione per infusione

Primary endpoint: The primary endpoints of the study are - for safety: incidence of adverse events of grade > 3 - for efficacy: disease control rate (according to RECIST 1.1) at 12 weeks after FMT. Disease control is defined as complete response, partial response and stable disease.
Endpoint(s): Characterization of patients’ microbiota both before and after FMT in terms of diversity and abundance of different microbiomal populations, Blood biomarkers: characterization of neutrophil and lymphocytic populations in terms of PD-1 PD-L1 expression, Neutrophil and Lymphocytes ratios, markers of inflammation (C-reactive proteins), LDH, RNAseq patterns

Source: https://euclinicaltrials.eu/ctis-public/view/2023-510504-45-00